EU clinical trial 2023-505594-32-00: A first-in-human study to learn about how safe BAY 3375968 is, how it moves into, through, and out of the body, and to find its best dose when given alone or with pembrolizumab in participants with advanced solid tumors
Protocol code: 21820
Sponsor: Bayer AG (Pharmaceutical company). Phase: Human Pharmacology (Phase I)- First administration to humans. Countries: Belgium (ongoing, recruitment ended), France (ongoing, recruitment ended), Spain (ongoing, recruitment ended).
Therapeutic area(s): Diseases [C] - Neoplasms [C04]
Gender: Female, Male. Age: 18-64 years, 65+ years. Enrolment: 103.
Status: Ongoing, recruitment ended. Start date (EU): 2024-02-20. Decision date: 2023-12-11. Results received: No. Last updated: 2026-04-15.
Decision dates by country: BE: 2023-12-11, ES: 2024-07-08, FR: 2024-08-29

Condition(s): Advanced solid tumors

Source: https://euclinicaltrials.eu/ctis-public/view/2023-505594-32-00